EU clinical trial 2024-512445-17-00: Add-on buprenorphine at analgesic doses for the treatment of severe suicidal ideas during a major depressive episode
Sponsor: Centre Hospitalier Universitaire De Nimes (Hospital/Clinic/Other health care facility). Phase: Therapeutic exploratory (Phase II). Countries: France (ongoing, recruiting).
Therapeutic area(s): Psychiatry and Psychology [F] - Mental Disorders [F03]
Gender: Female, Male. Age: 18-64 years. Enrolment: 180.
Status: Ongoing, recruiting. Start date (EU): 2021-07-01. Decision date: 2024-05-07. Results received: No. Last updated: 2026-07-06.

Condition(s): mental disorders
Product: BUPRENORPHINE, lactose monohydrate, BUPRENORPHINE

Primary endpoint: Scores on the Scale for Suicidal Ideation (SSI) at Day 7 for the last 7 days
Endpoint(s): Score on the SSI from D7 to 42 for the last 7 days (except at D2 = for the last 2 days), Psychological pain evaluation by a Visual Analog Scale (PPP-VAS) from D0 to D42 (current and for the last 7 days, except at D2 = for the last 2 days), Scores at the Beck Depression Inventory (BDI-II) and Montgomery-Asberg Depression Rating Scale (MADRS) after excluding the suicidal ideation items, for the last 7 days., Reports of the reasons for discontinuing treatment, Reports of suicide attempts and suicide completion after the treatment phase, Reports of side effects, Reports of withdrawal symptoms, Scores at neuropsychological tests, 3T Magnetic Resonance Imaging measurements, Blood and stool samples collection to create a biobank

Source: https://euclinicaltrials.eu/ctis-public/view/2024-512445-17-00